EU clinical trial 2025-523397-16-00: Phase IIb Multicenter Randomized Controlled Trial Evaluating the Efficacy of Sivelestat in Patients with Septic Coagulopathy
Protocol code: HUS n°9415
Sponsor: Les Hopitaux Universitaires De Strasbourg (Hospital/Clinic/Other health care facility). Phase: Therapeutic exploratory (Phase II). Countries: France (authorised, recruitment pending).
Therapeutic area(s): Analytical, Diagnostic and Therapeutic Techniques and Equipment [E] - Investigative Techniques [E05]; Diseases [C] - Immune System Diseases [C20]
Gender: Female, Male. Age: 18-64 years, 65+ years. Enrolment: 120.
Status: Authorised, recruitment pending. Decision date: 2026-06-05. Results received: No. Last updated: 2026-06-05.

Condition(s): Septic Coagulopathy
Product: SODIUM CHLORIDE, ELASPOL

Primary endpoint: Changes in plasma plasminogen levels after 24 hours of treatment with placebo or Sivelestat
Endpoint(s): Confirmatory secondary endpoints (mechanism-related) to document the biological and pathophysiological consistency of the treatment effect. Changes in coagulation and fibrinolysis biomarkers: • CBC, PT, antithrombin, D-dimers, plasminogen, plasmin, tPA, PAI-1, PAP measured on Day 1 (baseline), Day 2, Day 3, Day 4, and Day 7. • Normalization of the SIC score < 4 at Day 7. These endpoints will help document the kinetics of restoration of the coagulation–fibrinolysis balance under treatment, Exploratory clinical secondary endpoints These endpoints aim to explore the potential impact of the treatment on the clinical course of sepsis and organ dysfunction. • Sepsis Support Index (SSI) up to Day 28 • Penalized SSI up to Day 28 • SOFA score at Day 1, Day 2, Day 3, Day 4, and Day 7 • KDIGO criteria and use of renal replacement therapy at Day 7 • Thrombotic and hemorrhagic complications at Day 7, Exploratory resource use and prognostic endpoints to explore a potential impact on the care trajectory. • Number of days free from mechanical ventilation at Day 28 • Number of days free from vasopressor support at Day 28 • Number of days free from ICU stay at Day 28 • Number of days free from hospitalization at Day 90 • Mortality at Day 7, Day 28, and Day 90 These endpoints will be analyzed for exploratory purposes only, in order to generate hypotheses for future confirmatory trials, Safety Safety will be assessed by: • systematic collection of adverse events (AEs) • collection of serious adverse events (SAEs) with particular attention paid to hemorrhagic and thrombotic events, given the mechanism of action of the treatment

Source: https://euclinicaltrials.eu/ctis-public/view/2025-523397-16-00